EU clinical trial 2024-516479-34-00: A Randomized, Controlled Phase 3 Study of Cabozantinib (XL184) in Combination with Atezolizumab versus Sorafenib in Subjects with Advanced Hepatocellular Carcinoma Who Have Not Received Previous Systemic Anticancer Therapy
Protocol code: XL184-312
Sponsor: Exelixis Inc. (Pharmaceutical company). Phase: Therapeutic confirmatory (Phase III). Countries: Spain (ended), Hungary (ended), France (ongoing, recruitment ended), Belgium (ended), Romania (ongoing, recruitment ended).
Therapeutic area(s): Diseases [C] - Neoplasms [C04]
Gender: Female, Male. Age: 18-64 years, 65+ years. Enrolment: 7.
Start date (EU): 2019-05-17. Decision date: 2024-10-14. Results received: No. Last updated: 2025-11-04.
Decision dates by country: BE: 2024-10-14, FR: 2024-10-14, HU: 2024-10-14, RO: 2024-10-21, ES: 2024-10-14

Condition(s): Hepatocellular carcinoma
Product: Nexavar 200 mg film-coated tablets, CABOMETYX 20 mg film-coated tablets, Tecentriq 1 200 mg concentrate for solution for infusion, CABOMETYX 60 mg film-coated tablets

Primary endpoint: Duration of Progression Free Survival (PFS) per RECIST 1.1, by Blinded Independent Radiology Committee (BIRC) for the experimental arm (cabozantinib+atezolizumab) vs the control arm ( sorafenib), Duration of Overall Survival (OS) for the experimental arm (cabozantinib+atezolizumab) vs the control arm (sorafenib)
Endpoint(s): PFS per RECIST 1.1 by BIRC for the single-agent cabozantinib arm vs the control arm (sorafenib)

Source: https://euclinicaltrials.eu/ctis-public/view/2024-516479-34-00